EU clinical trial 2023-504641-32-00: A geroscience approach to post-acute COVID-19 syndrome (PACS) by Diet and Exercise plus rapamycin or metformin to treat Frailty and restore immune functions: a randomized, single center clinical trial.
Protocol code: Gero-PACS
Sponsor: Azienda Ospedaliero Universitaria Di Modena (Hospital/Clinic/Other health care facility). Phase: Therapeutic exploratory (Phase II). Countries: Italy (not authorised).
Therapeutic area(s): Diseases [C] - Virus Diseases [C02]
Gender: Female, Male. Age: 18-64 years, 65+ years. Enrolment: 60.
Status: Not authorised. Decision date: 2023-07-13. Results received: No. Last updated: 2023-07-13.

Condition(s): Post-acute COVID syndrome(PACS) diagnosis.
Product: METFORMIN, METFORMIN, SIROLIMUS

Primary endpoint: Short Physical Performance Battery, Frailty reversibility, Quality of life assessed with EQ 5D-5L
Endpoint(s): Identification of the main changes in peripheral blood cells that identify the immune risk phenotype (CD4/CD8 T cell ratio, senescent/activated CD8+ T cells, number of B lymphocytes and NK cells), Evaluation of the change that occur in the plasma level of the main inflammatory and anti-inflammatory cytokines, chemokines and their receptors., Analysis of the differences in monocyte activation and phenotypes (inflammatory, classical, non classical) among groups, The occurrence of adverse events (AEs), changes on clinical examination including vital signs and weight, and laboratory examinations (biochemistry, hematology and urinalysis)

Source: https://euclinicaltrials.eu/ctis-public/view/2023-504641-32-00